EU clinical trial 2024-514206-31-00: “Phase I/II, Multicenter, Open-label, Clinical and Pharmacokinetic Study of Lurbinectedin (PM01183) in Combination with Pembrolizumab in Patients with Relapsed Small Cell Lung Cancer (the LUPER study).”
Protocol code: MEDOPP300
Sponsor: Dr.Antonio Calles Blanco (Hospital/Clinic/Other health care facility). Phase: Phase I and Phase II (Integrated)- Other. Countries: Spain (ended).
Therapeutic area(s): Diseases [C] - Neoplasms [C04]
Gender: Female, Male. Age: 18-64 years, 65+ years. Enrolment: 21.
Status: Ended. Start date (EU): 2020-07-09. End date (EU): 2025-05-20. Decision date: 2024-07-23. Results received: Yes. Last updated: 2025-02-20.

Condition(s): Small cell lung cancer (SCLC).
Product: KEYTRUDA 25 mg/mL concentrate for solution for infusion, lurbinectedin

Primary endpoint: Stage I: (1) Determination of MTD and RD: • The MTD will be the lowest dose level explored during dose escalation at which more than one third of evaluable patients develop a DLT in Cycle 1. • The RD will be the highest dose level explored at which less than one third of evaluable patients develop a DLT during Cycle 1., Stage I: (1 cont.) If the DLTs of the PM01183 and pembrolizumab combination without G-CSF prophylaxis are exclusively related to neutropenia, the MTD and RD will also be determined with primary G-CSF prophylaxis., Stage I: (2) DLTs are defined as any adverse events (AEs) and laboratory abnormalities related to the study treatment during the first cycle of treatment and fulfilling at least one of the criteria outlined below., Stage I: (2 cont.) • Grade 4 neutropenia (absolute neutrophil count [ANC] <0.5 x 109/L) lasting >3 days. • Grade 3 neutropenia (ANC: 0.5-1.0 x 109/L) lasting >7 days. • Febrile neutropenia of any duration or neutropenic sepsis. • Grade 4 thrombocytopenia (platelet count <25 x 109/L) or grade 3 with any major bleeding episode requiring a platelet transfusion. • Grade 4 alanine aminotransferase (ALT) and/or aspartate aminotransferase (AST) increase, or grade 3 increase lasting >14 days., Stage I: (2 cont.2) • Grade ≥2 ALT or AST increase concomitantly with total bilirubin increase ≥2.0 x upper limit of normal (ULN) and normal alkaline phosphatase (AP). • Grade ≥3 creatine phosphokinase (CPK) increase., Stage I: (2 cont. 3) • Any other grade 3/4 non-hematological AE that is suspected to be related to study drug(s), except nausea/vomiting (unless the patient is receiving an optimal anti- emetic regimen), hypersensitivity reactions, extravasations, grade 3 asthenia lasting less than one week, and non-clinically relevant isolated biochemical abnormalities (e.g., isolated increase in gamma-glutamyltransferase [GGT])., Stage I: (2 cont. 4) Delay in the administration of Cycle 2 of the combination exceeding 15 days of the theoretical date (i.e., Day 22), due to any AEs related to the study drug(s)., Stage II: The primary objective of this stage is to assess the antitumor activity of PM01183 combined with pembrolizumab in terms of ORR, defined as the percentage of evaluable patients with a confirmed response, either complete (CR) or partial (PR)., Stage II: (cont.) The ORR will be assessed using the RECIST 1.1 on a set of measurable lesions identified at baseline as target lesions or as non-target lesions (if any), and followed until PD by an appropriate method (e.g., helical computed tomography [CT]-scan, magnetic resonance imaging [MRI])., Stage II: (cont. 2) Radiological tumor assessment will be performed at baseline, and every 2 cycles from the onset of the study treatment until evidence of PD. If an objective response is observed, according to the RECIST 1.1, it must be confirmed by the same method at least 4 weeks after the date of the first documentation of response., Stage II: (cont. 3) The date of response, the date of radiological or clinical PD, and the date of death will be registered and documented, as appropriate.
Endpoint(s): Both stages: Safety:AEs will be graded according to the NCI-CTCAE v.5. Additionally, treatment compliance, in particular dose reduction requirements, skipped doses and/or cycle delays due to AEs, will be described., Both stages:Efficacy: preliminary antitumor activity will be evaluated according to the RECIST 1.1 (and the iRECIST 1.1, whenever applicable), Both stages: Pharmacokinetics: PK parameters will be evaluated in plasma by standard noncompartmental methods (compartmental modeling may be performed if appropriate)., Both stages:Pharmacogenetics: analyze germline DNA for the presence or absence of mutations or polymorphisms in genes relevant for the metabolism and/or transport of PM01183 that may help explain individual variability in main PK parameters., Pharmacogenomics:The mutational status of factors involved in DNA repair mechanisms, or related to the mechanism of action of PM01183 or pembrolizumab, will be evaluated from available prior paraffin-embedded tumor tissue samples obtained at diagnosis or relapse. mRNA and/or protein expression levels of these factors might be also analyzed, if relevant. Potentially whole exome sequencing will also be analyzed. Their correlation with the clinical response and outcome after treatment, Biomarker research: Both stages: Molecular assessments may be performed with the material derived from plasma samples, using both hypothesis-driven and discovery-based approaches, in order to explore potential molecular patterns correlating with sensitivity/resistance to the treatment.

Source: https://euclinicaltrials.eu/ctis-public/view/2024-514206-31-00